EU clinical trial 2023-503617-30-02: Boosting recovery through excitation of arousal and awareness in comatose patients: Dose finding study (BREA2KTHROUGH DOSEFINDER)
Sponsor: Rigshospitalet (Hospital/Clinic/Other health care facility). Phase: Human Pharmacology (Phase I)- Other. Countries: Denmark (ongoing, recruiting).
Therapeutic area(s): Diseases [C] - Nervous System Diseases [C10]
Gender: Female, Male. Age: 18-64 years, 65+ years. Enrolment: 384.
Status: Ongoing, recruiting. Start date (EU): 2025-02-26. Decision date: 2024-05-28. Results received: No. Last updated: 2026-06-11.

Condition(s): Coma and other disorders of consciousness due to acute traumatic and non-traumatic brain injury
Product: PEX010 Psilocybin Capsules ( 25mg psilocybin), Apomorfin PharmSwed 5 mg/ml infusjonsvæske, oppløsning, Natriumklorid Fresenius Kabi 9 mg/ml infusjonsvæske, oppløsning

Primary endpoint: Time to awakening within 30 days (overall safety)
Endpoint(s): Number of participants with one or more SARs/SAEs at day 30, Any neuropsychiatric side effects until day 50 (e.g., hallucinations, anxiety, suicidality, signs of other psychological distress) after receiving psilocybin that warrants medical attention by the attending physicians using standard clinical care like application of sedatives/benzodiazepines and/or neuroleptic medication and non-pharmacological interventions, Improvement of conscious state after administration of psylocibin (at three different doses) and apomorphine, as measured by FOUR (≥2 points) and/or SECONDs (≥1 point) scores, at day 1 (exploratory endpoint), Improvement of conscious state after administration of apomorphine plus 1 mg, 10 mg or 25 mg psylocibin, as measured by clinical outcome at day 1 (improvement across DoC categories, e.g., from VS/UWS to MCS-), FOUR (≥2 points) and/or SECONDs (≥1 point) scores at day 7, and as measured by GOS-E (≥1 point) at day 90 (exploratory endpoint), Significantly larger median pupillary size during passive and active paradigms compared to the immediate rest periods prior and after administration of psilocybin and apomorphine, as measured by automated pupillometer (exploratory endpoint), Neurovascular coupling (NIRS-EEG) measures combined with EEG features from our machine learning algorithm following administration of psylocibin and apomorphine, and cortical activation during tongue mental imagery paradigm (exploratory endpoint)

Source: https://euclinicaltrials.eu/ctis-public/view/2023-503617-30-02